EU clinical trial 2025-524165-25-00: First time in human (FTIH) study to investigate the safety and preliminary activity of GSK5533524 alone or in combination in adult participants with advanced solid tumors
Protocol code: 300163
Sponsor: Glaxosmithkline Research & Development Limited (Pharmaceutical company). Phase: Human Pharmacology (Phase I)- First administration to humans. Countries: Spain (ongoing, recruiting), Denmark (authorised, recruitment pending), Finland (authorised, recruitment pending), France (authorised, recruitment pending).
Therapeutic area(s): Diseases [C] - Neoplasms [C04]
Gender: Female, Male. Age: 18-64 years, 65+ years. Enrolment: 52.
Start date (EU): 2026-06-10. Decision date: 2026-05-21. Results received: No. Last updated: 2026-07-20.
Decision dates by country: DK: 2026-05-22, FR: 2026-07-20, ES: 2026-05-22, FI: 2026-05-28

Condition(s): Neoplasms

Source: https://euclinicaltrials.eu/ctis-public/view/2025-524165-25-00